EU clinical trial 2023-507048-35-00: Randomized, open-label, single dose, three-period, three treatment cross-over bioavailability study comparing test products Rosuvastatin/Ezetimibe, tablets, 20 mg /10 mg or Ezehron Duo, 20 mg + 10 mg, tablet, both administered in combination with Nilemdo 180 mg film-coated tablets to reference products Nustendi 180 mg/10 mg film-coated tablets in combination with Crestor, 20 mg, film-coated tablets in healthy male and female subjects under fasting conditions.
Protocol code: 950/23
Sponsor: Adamed Pharma S.A. (Pharmaceutical company). Phase: Human Pharmacology (Phase I)- Other. Countries: Czechia (ended).
Therapeutic area(s): Diseases [C] - Cardiovascular Diseases [C14]
Gender: Female, Male. Age: 18-64 years. Enrolment: 24.
Status: Ended. Start date (EU): 2023-10-11. End date (EU): 2024-01-04. Decision date: 2023-10-02. Results received: Yes. Last updated: 2023-10-02.

Condition(s): not applicable (submitted trial is bioavailability study in healthy subjects)
Product: Ezehron Duo, 20 mg + 10 mg, tabletka, Nustendi 180 mg/10 mg film-coated tablets, Nilemdo 180 mg film-coated tablets, Rosuvastatin/Ezetimibe, tablets, 20 mg/10 mg, Crestor, 20 mg, tabletki powlekane, Heparin Léčiva Injekční roztok

Primary endpoint: AUC(0-72h) or AUC(0-t), and Cmax. 90% confidence intervals for the Treatment A or Treatment C to Treatment B ratios of LSM for rosuvastatin and total ezetimibe based on ln-transformed data of AUC(0-t) or AUC(0-72h) and Cmax will be calculated and compared with acceptance limits : AUC(0-t) or AUC(0-72h) 80.00 ‒ 125.00% ; Cmax 80.00 ‒ 125.00%
Endpoint(s): tmax, AUC(0-∞), AUCres, t1/2 and λz (if applicable)

Source: https://euclinicaltrials.eu/ctis-public/view/2023-507048-35-00